EU clinical trial 2024-514489-38-01: CD8 T cell imaging by positron emission tomography with 89Zr-Df-crefmirlimab in giant cell arteritis and rheumatoid arthritis: a pilot study
Sponsor: Universitair Medisch Centrum Groningen (Hospital/Clinic/Other health care facility). Phase: Therapeutic exploratory (Phase II). Countries: Netherlands (ongoing, recruiting).
Therapeutic area(s): Diseases [C] - Cardiovascular Diseases [C14]; Diseases [C] - Musculoskeletal Diseases [C05]
Gender: Female, Male. Age: 18-64 years, 65+ years. Enrolment: 20.
Status: Ongoing, recruiting. Start date (EU): 2024-11-26. Decision date: 2024-07-29. Results received: No. Last updated: 2026-08-05.

Condition(s): giant cell arteritis, rheumatoid arthritis
Product: Zr89

Primary endpoint: The primary 89Zr-Df-crefmirlimab PET/CT measurements are the tracer uptake in different arteries or joints whereby the radioactivity concentration in Regions-of-Interest (ROIs) are expressed as SUVs (Standardized Uptake Values).

Source: https://euclinicaltrials.eu/ctis-public/view/2024-514489-38-01